EU clinical trial 2024-516878-30-00: A clinical study of MK-6916 and placebo in healthy people (MK-6916-003)
Protocol code: MK-6916-003
Sponsor: Merck Sharp & Dohme LLC (Pharmaceutical company). Phase: Human Pharmacology (Phase I)- Other. Countries: Belgium (ended).
Therapeutic area(s): Diseases [C] - Nervous System Diseases [C10]
Gender: Male. Age: 18-64 years. Enrolment: 16.
Status: Ended. Start date (EU): 2024-12-10. End date (EU): 2025-04-08. End date: 2025-04-09. Decision date: 2024-12-03. Results received: No. Last updated: 2024-12-03.

Condition(s): Acute and chronic Pain

Source: https://euclinicaltrials.eu/ctis-public/view/2024-516878-30-00